EU clinical trial 2022-500680-13-00: Pan-lesions SBRT combined with lymphocyte support through ATRA-driven blockade of MDSC in patients with oligometastatic solid cancer (LySATRA)
Protocol code: LySATRA 2022/3511
Sponsor: Institut Gustave Roussy (Hospital/Clinic/Other health care facility). Phase: Phase I and Phase II (Integrated)- Other. Countries: France (ongoing, recruiting).
Therapeutic area(s): Diseases [C] - Neoplasms [C04]
Gender: Female, Male. Age: 18-64 years, 65+ years. Enrolment: 64.
Status: Ongoing, recruiting. Start date (EU): 2024-07-04. Decision date: 2024-03-04. Results received: No. Last updated: 2026-07-21.

Condition(s): Oligometastatic solid cancer
Product: VESANOID 10 mg, capsule molle

Primary endpoint: Part I: safety Dose-limiting toxicity (DLT) is defined as an adverse event reported during the first three weeks of treatment that is possibly related to study intervention and fulfills any one of the following criteria using CTCAE Version 5.0: (...)Part II: efficacy on lymphoprotection The primary evaluation criterion is the rate of patients with lymphopenia grade ≥ 2 at 6 weeks after treatment completion, defined as an absolute lymphocyte count < 800/mm3 (CTCAE V5.0).
Endpoint(s): Secondary endpoints include: - Duration and grading of lymphopenia over time; - Overall safety; - Treatment compliance, rate and reasons of discontinuation; -Overall Survival; -Progression Free Survival, Exploratory endpoints include (and may not be limited to): s immunomonitoring - Characterization of the i- Circulating T cellmmune infiltrate before/during treatment using immunohistochemistry and RNA-sequencing of tumor lesions, respectively on FFPE and freshly frozen biopsies (in-field and out of the radiation field) - Biological dosimetry on circulating lymphocytes (as in Gruel G et al., Rad Res 2013) -(...)

Source: https://euclinicaltrials.eu/ctis-public/view/2022-500680-13-00